EU clinical trial 2023-505077-32-00: A Phase III, Randomised, Open-label, Global Study of Datopotamab Deruxtecan (Dato-DXd) in Combination With Rilvegostomig (AZD2936) or Rilvegostomig Monotherapy Versus Pembrolizumab Monotherapy for the First-line Treatment of Participants With Locally-advanced or Metastatic Non-squamous NSCLC With High PD-L1 Expression (TC ≥ 50%) and Without Actionable Genomic Alterations (TROPION-Lung10)
Protocol code: D7632C00001
Sponsor: AstraZeneca AB (Pharmaceutical company). Phase: Therapeutic confirmatory (Phase III). Countries: Germany (ongoing, recruiting), Italy (ongoing, recruiting), Hungary (ongoing, recruiting), Poland (ongoing, recruiting), Spain (ongoing, recruiting), Austria (ongoing, recruiting), Belgium (ongoing, recruiting).
Therapeutic area(s): Diseases [C] - Neoplasms [C04]
Gender: Female, Male. Age: 18-64 years, 65+ years. Enrolment: 189.
Status: Ongoing, recruiting. Start date (EU): 2025-01-28. Decision date: 2024-06-20. Results received: No. Last updated: 2026-05-27.
Decision dates by country: BE: 2024-06-20, ES: 2024-06-24, IT: 2025-03-13, PL: 2024-06-24, HU: 2024-06-25, DE: 2024-06-24, AT: 2024-06-28

Condition(s): Locally-advanced or metastatic non-squamous non-small cell lung cancer (NSCLC) with high PD-L1 expression (TC ≥ 50%) and without actionable genomic alterations.
Product: Datopotamab deruxtecan, Rilvegostomig, MYCOPHENOLATE MOFETIL, INFLIXIMAB, KEYTRUDA 25 mg/mL concentrate for solution for infusion

Primary endpoint: Assessment of PFS by BICR in TROP2 biomarker positive participants., Assessment of OS in TROP2 biomarker positive participants.
Endpoint(s): Assessment of PFS by BICR in the FAS population., Assessment of OS in the FAS population., Objective Response Rate (ORR), Duration of Response (DoR), Participant-reported lung cancer symptoms of NSCLC and participant-reported GHS/QOL in participants treated with Dato-DXd in combination with rilvegostomig relative to pembrolizumab, Pharmacokinetics (PK), Immunogenicity, Second Progression-Free Survival (PFS2), Safety and tolerabillity evaluated in terms of AEs

Source: https://euclinicaltrials.eu/ctis-public/view/2023-505077-32-00